EU clinical trial 2023-507140-37-00: A Phase 2 study of durcabtagene autoleucel, B-cell maturation Antigen (BCMA)-directed CAR-T Cells in adult participants with relapsed and refractory multiple myeloma
Protocol code: CPHE885B12201
Sponsor: Novartis Pharma AG (Pharmaceutical company). Phase: Therapeutic exploratory (Phase II). Countries: Spain (ended), Greece (ended), Italy (ended), Germany (ended), France (ended).
Therapeutic area(s): Diseases [C] - Neoplasms [C04]
Gender: Female, Male. Age: 18-64 years, 65+ years. Enrolment: 61.
Status: Ended. Start date (EU): 2022-06-22. End date (EU): 2025-05-19. End date: 2025-05-21. Decision date: 2024-07-12. Results received: Yes. Last updated: 2025-01-27.
Decision dates by country: FR: 2024-07-18, DE: 2024-07-15, GR: 2024-10-01, ES: 2024-07-12, IT: 2024-08-05

Condition(s): Adult patients with relapsed and refractory multiple myeloma
Product: FLUDARABINE PHOSPHATE, TOCILIZUMAB, CYCLOPHOSPHAMIDE, BENDAMUSTINE, PHE885

Primary endpoint: Best overall response (BOR) per IRC defined as the best disease response recorded from durcabtagene autoleucel administration until PD, death or starting new anticancer therapy whichever comes first, with possible values of either sCR, CR, VGPR, PR, MR, SD, PD or unknown , according to the IMWG criteria. The summary measure for the primary endpoint isORR, defined as the proportion of participants with a BOR of PR or better, assessed in the efficacy analysis set
Endpoint(s): Proportion of participants who achieved MRD negative status at any time point within 3 months of achieving at least CR until the time of PD, death or starting new anticancer therapy, whichever comes first., CRR defined as the proportion of participants with BOR of sCR or CR., TTR defined as time from durcabtagene autoleucel administration to the date of first documented response (PR or better)., DOR defined as time from first documented response (PR or better) until relapse or death due to any cause., PFS defined as time from durcabtagene autoleucel administration until progression or death due to any cause., TTNT defined as time from durcabtagene autoleucel administration until start of new anti-myeloma therapy or death due to any cause., OS defined as time from durcabtagene autoleucel administration until death due to any cause., Duration from the start of undetectable MRD to the time of reappearance of detectable MRD., Summary scores of PRO measured by EQ-5D-5L, EORTC-QLQ-C30 and EORTC-QLQ-MY20., Proportion of enrolled participants for whom a durcabtagene autoleucel product was manufactured that met all release specifications., Time from pick up of cryopreserved material at the clinic or hospital until return to the clinic or hospital., Type, frequency, and severity of adverse events, serious adverse events, adverse events of special interest (AESIs) and laboratory abnormalities., Transgene of durcabtagene autoleucel concentrations over time in peripheral blood and bone marrow determined by quantitative PCR Cellular kinetics parameters: Cmax (maximum serum concentration), Tmax (time to reach Cmax), AUCs and other cellular kinetic parameters., Summary of pre-existing and treatment-induced immunogenicity (cellular and humoral) of durcabtagene autoleucel. Correlate levels of pre-existing and treatment-induced immunogenicity with cellular kinetic parameters, safety and efficacy

Source: https://euclinicaltrials.eu/ctis-public/view/2023-507140-37-00